EU clinical trial 2025-521468-36-00: Intraperitoneal irinotecan combined with systemic therapy for patients with gastric peritoneal metastases: A phase II, multicenter study
Sponsor: Erasmus Universitair Medisch Centrum Rotterdam (Erasmus MC) (Hospital/Clinic/Other health care facility). Phase: Therapeutic exploratory (Phase II). Countries: Netherlands (ongoing, recruiting).
Therapeutic area(s): Diseases [C] - Neoplasms [C04]
Gender: Female, Male. Age: 18-64 years, 65+ years. Enrolment: 49.
Status: Ongoing, recruiting. Start date (EU): 2025-09-29. Decision date: 2025-09-15. Results received: No. Last updated: 2025-09-15.

Condition(s): Gastric peritoneal metastases
Product: Irinotecan Accord 20 mg/ml concentraat voor oplossing voor infusie

Primary endpoint: Feasibility, determined as the percentage of patients completing all cycles of systemic therapy in combination with intraperitoneal irinotecan
Endpoint(s): Overall survivall, calculated from date of PM until death or last follow-up, Safety of the administered treatment, assessed by all treatment-related AEs, all SAEs, percentage of patients discontinuing treatment due to treatment-related AEs, Overall respons rate of iriotecan in combination with systemic therapy for patients with PM of GC, assessed by the percentage of patients demonstrating response of the the treatment, Progression-free survival calculated from date of PM until progression or last follow-up, QoL at baseline, after the first cycle, after the first radiological response evaluation, and after the last cycle, assessed by: EQ-5D-5L,QLQ-C30 and QLQ-STO22., Healthcare costs and costs due to productivity losses during and after treatment with IP irinotecan in combination with systemic therapy for patients with PM of GC assessed by questionnaires

Source: https://euclinicaltrials.eu/ctis-public/view/2025-521468-36-00